EU clinical trial 2024-517972-39-00: A phase 3, multicenter, randomized, double-blind, placebo- controlled, parallel-group study with an open-label period and long-term extension to assess the efficacy and safety of rilzabrutinib in participants with warm autoimmune hemolytic anemia (wAIHA)
Protocol code: EFC17360 - LUMINA 3
Sponsor: Sanofi-Aventis Recherche & Developpement (Pharmaceutical company). Phase: Therapeutic confirmatory (Phase III). Countries: Netherlands (ongoing, recruiting), Greece (ongoing, recruiting), Sweden (ongoing, recruiting), Spain (ongoing, recruiting), Hungary (ongoing, recruiting), Czechia (ongoing, recruiting), Italy (ongoing, recruiting), Poland (ongoing, recruiting), Germany (ongoing, recruiting), Austria (ongoing, recruiting), Denmark (authorised, recruitment pending).
Therapeutic area(s): Diseases [C] - Immune System Diseases [C20]
Gender: Female, Male. Age: 18-64 years, 65+ years. Enrolment: 58.
Start date (EU): 2025-08-19. Decision date: 2025-07-07. Results received: No. Last updated: 2026-07-08.
Decision dates by country: HU: 2025-07-07, ES: 2025-07-09, GR: 2025-07-11, IT: 2025-07-10, CZ: 2025-07-09, SE: 2025-07-10, DK: 2025-07-08, DE: 2025-07-11, NL: 2025-07-08, AT: 2025-07-14, PL: 2025-07-14

Condition(s): Autoimmune haemolytic anaemia
Product: Sar444671 placebo - matched placebo for test, Rilzabrutinib

Primary endpoint: Proportion of participants achieving DHR. DHR is defined as an increase of Hb by ≥2 g/dL from baseline on at least two thirds of evaluable scheduled visits between Week 12 and Week 24 (inclusive) in the PAP
Endpoint(s): Proportion of participants achieving overall Hb response (response [R] or complete response [CR]) by Week 24 of treatment in the PAP, Change from baseline in fatigue total score as measured by Functional Assessment of Chronic Illness Therapy (FACIT) – fatigue at Week 24, The time taken (days) to achieve the first Hb increase by ≥2 g/dL from baseline during the PAP in the absence of transfusion in the previous 14 days and in the absence of rescue medication in the previous 6 weeks, Change from baseline in levels of LDH at Week 24, Proportion of participants requiring use of rescue therapy after Week 4 of treatment during the PAP, Change from baseline in dyspnea severity score as measured by FACIT-Dyspnea at Week 24, Incidence of treatment-emergent adverse events (TEAEs), treatment-emergent serious adverse events (SAEs), treatment-emergent adverse events of special interest (AESIs), as well as clinical laboratory evaluations, vital sign, physical exam, and electrocardiograms (ECG)

Source: https://euclinicaltrials.eu/ctis-public/view/2024-517972-39-00